EU clinical trial 2025-522553-19-00: A Phase 2b/3, Adaptive, Randomized, Double-blind, Placebo-controlled, Multicenter Study to Assess the Efficacy and Safety of Danicamtiv in Participants with Symptomatic Genetic and Familial Dilated Cardiomyopathy (KINSHIP-DCM).
Protocol code: DAN-301
Sponsor: Kardigan Inc. (Pharmaceutical company). Phase: Phase II and Phase III (Integrated). Countries: Spain (ongoing, recruiting), Denmark (ongoing, recruiting), Belgium (ongoing, recruiting), Hungary (ongoing, recruiting), Italy (ongoing, recruiting), Poland (ongoing, recruiting), France (ongoing, recruiting), Sweden (ongoing, recruiting), Netherlands (authorised, recruiting).
Therapeutic area(s): Diseases [C] - Cardiovascular Diseases [C14]
Gender: Female, Male. Age: 18-64 years, 65+ years. Enrolment: 240.
Start date (EU): 2026-02-25. Decision date: 2026-01-30. Results received: No. Last updated: 2026-06-26.
Decision dates by country: NL: 2026-02-02, HU: 2026-02-02, FR: 2026-02-04, BE: 2026-02-03, IT: 2026-02-02, SE: 2026-01-30, ES: 2026-02-04, DK: 2026-02-02, PL: 2026-02-03

Condition(s): Symptomatic genetic and familial dilated cardiomyopathy.
Product: Danicamtiv, Placebo tablets contain the same excipients as Danicamtiv tablets except the active substance.

Primary endpoint: Change from Baseline (Day 1) to Week 26 in left atrial function index (LAFI) in Cohort 1., Change from Baseline to Week 26 in peak oxygen consumption (pVO2) in Cohort 1.

Source: https://euclinicaltrials.eu/ctis-public/view/2025-522553-19-00